EU clinical trial 2024-511481-37-00: C4251003- A Phase 2 Basket Study of Tucatinib in Combination with Trastuzumab in Subjects with Previously Treated, Locally Advanced Unresectable or Metastatic Solid Tumors Driven by HER2 Alterations.
Protocol code: SGNTUC-019
Sponsor: Seagen Inc. (Pharmaceutical company). Phase: Therapeutic exploratory (Phase II). Countries: Germany (ended), Belgium (ended), Spain (ended).
Therapeutic area(s): Diseases [C] - Neoplasms [C04]
Gender: Female, Male. Age: 18-64 years, 65+ years. Enrolment: 29.
Status: Ended. Start date (EU): 2021-07-12. End date (EU): 2026-01-21. Decision date: 2024-04-09. Results received: No. Last updated: 2025-06-17.
Decision dates by country: BE: 2024-04-15, ES: 2024-04-09, DE: 2024-04-09

Condition(s): Previously Treated, Locally-Advanced Unresectable or Metastatic Solid Tumors Driven by HER2 Alterations
Product: TUKYSA 150 mg film-coated tablets, Herceptin 150 mg powder for concentrate for solution for infusion, Faslodex 250 mg solution for injection., Fulvestrant Mylan 250 mg solution for injection in prefilled syringe, TUKYSA 50 mg film-coated tablets

Primary endpoint: Confirmed objective response rate (ORR; confirmed complete response [CR] or partial response [PR]) according to Response Evaluation Criteria in Solid Tumors (RECIST) v1.1 per investigator assessment
Endpoint(s): Disease control rate (DCR; confirmed CR or PR, or stable disease) per investigator assessment, Duration of response (DOR; confirmed CR or PR) per investigator Assessment Progression-free survival (PFS) per investigator assessment, Overall survival (OS), Type, incidence, severity, seriousness, and relatedness of adverse events (AEs), Type, incidence, and severity of laboratory abnormalities, Frequency of treatment interruptions, dose reductions, and treatment discontinuations due to AEs, Other relevant safety variables including AEs of special interest (AESIs)

Source: https://euclinicaltrials.eu/ctis-public/view/2024-511481-37-00